EU clinical trial 2025-522204-24-00: J2R-MC-YAAD: A Phase 2, Double-blind, Placebo-Controlled Study to Evaluate LY3537021 for the Treatment of Chemotherapy-Induced Nausea and Vomiting in Adult Participants With Malignant Disease
Protocol code: J2R-MC-YAAD
Sponsor: Eli Lilly & Co. (Pharmaceutical company). Phase: Therapeutic exploratory (Phase II). Countries: Romania (ongoing, recruiting), Spain (ongoing, recruiting), France (ongoing, recruiting), Italy (authorised, recruiting).
Therapeutic area(s): Diseases [C] - Neoplasms [C04]
Gender: Female, Male. Age: 18-64 years. Enrolment: 77.
Start date (EU): 2026-06-16. Decision date: 2026-02-23. Results received: No. Last updated: 2026-07-13.
Decision dates by country: FR: 2026-02-23, RO: 2026-03-02, ES: 2026-02-27, IT: 2026-02-25

Condition(s): Neoplasms, Vomiting, Drug-Related Side Effects and Adverse Reactions, Nausea
Product: 0.9% sodium chloride, GRANISETRON, PALONOSETRON, COMBINATIONS, APREPITANT, DEXAMETHASONE, PALONOSETRON, ONDANSETRON, Lagipra

Primary endpoint: Proportion of Participants with a Complete Response (CR) in the Delayed Phase of CINV CR defined as no vomiting and no rescue medication

Source: https://euclinicaltrials.eu/ctis-public/view/2025-522204-24-00